EU clinical trial 2023-505980-36-00: A Phase IIIb Multicenter, Randomized, Double-Blind, Placebo-Controlled Study to Evaluate the Efficacy and Safety of Ocrelizumab in Adults With Primary Progressive Multiple Sclerosis
Protocol code: WA40404
Sponsor: F. Hoffmann-La Roche AG (Pharmaceutical company). Phase: Therapeutic confirmatory (Phase III). Countries: France (ongoing, recruitment ended), Italy (ongoing, recruitment ended), Romania (ongoing, recruitment ended), Bulgaria (ongoing, recruitment ended), Portugal (ongoing, recruitment ended), Poland (ongoing, recruitment ended), Croatia (ongoing, recruitment ended), Belgium (ongoing, recruitment ended), Spain (ongoing, recruitment ended).
Therapeutic area(s): Diseases [C] - Immune System Diseases [C20]; Diseases [C] - Nervous System Diseases [C10]
Gender: Female, Male. Age: 18-64 years. Enrolment: 363.
Status: Ongoing, recruitment ended. Start date (EU): 2019-09-19. Decision date: 2024-01-31. Results received: No. Last updated: 2026-07-09.
Decision dates by country: HR: 2024-02-02, BE: 2024-02-05, BG: 2024-02-05, RO: 2024-02-05, PT: 2024-01-31, FR: 2024-01-31, IT: 2024-02-16, PL: 2024-02-25, ES: 2024-02-01

Condition(s): Primary progressive multiple sclerosis (PPMS)
Product: Placebo Ocrevus, Ocrevus 300 mg concentrate for solution for infusion, METHYLPREDNISOLONE SODIUM SUCCINATE, Dormutil N, METHYLPREDNISOLONE, METHYLPREDNISOLONE SODIUM SUCCINATE, METHYLPREDNISOLONE SODIUM SUCCINATE, Ocrevus 300 mg concentrate for solution for infusion, METHYLPREDNISOLONE SODIUM SUCCINATE, DIPHENHYDRAMINE HYDROCHLORIDE

Primary endpoint: 1. Time to onset of composite 12-week CDP defined as the time from randomization to the first occurrence of either 12-week CDP in 9-HPT, or 12-week CDP in EDSS
Endpoint(s): 1. Time to 12-week CDP in EDSS, as a pre-defined increase in EDSS score confirmed for at least 12 weeks, 2. Time to 24-week CDP in 9-HPT, 3. Time to 24-week CDP in EDSS, as a pre-defined increase in EDSS score confirmed for at least 24 weeks, 4. Annual rate of percent change from baseline in total volume of T2 lesions, 5. Annual rate of percent change from Week 24 in total brain volume, 6. Incidence and nature of adverse events, serious adverse events, adverse events leading to study treatment withdrawal, 7. Change from baseline in laboratory test results for hematology and chemistry association of decrease in certain laboratory parameters, and serious infections, 8. Presence of ADA during the study relative to baseline, 9. Total plasma clearances (CL) of ocrelizumab, 10. Volumes of distribution(Vd) of ocrelizumab, 11. Area under the concentration-time curve (AUC) of ocrelizumab

Source: https://euclinicaltrials.eu/ctis-public/view/2023-505980-36-00